EU clinical trial 2024-513537-21-02: [18F]PEG-folate PET-CT imaging for monitoring of therapy response in Rheumatoid Arthritis patients
Sponsor: Amsterdam UMC Stichting (Hospital/Clinic/Other health care facility). Phase: Therapeutic exploratory (Phase II). Countries: Netherlands (ongoing, recruiting).
Therapeutic area(s): Diseases [C] - Immune System Diseases [C20]; Diseases [C] - Musculoskeletal Diseases [C05]
Gender: Female, Male. Age: 18-64 years, 65+ years. Enrolment: 20.
Status: Ongoing, recruiting. Start date (EU): 2024-11-27. Decision date: 2024-11-27. Results received: No. Last updated: 2024-11-27.

Condition(s): Rheumatoid Arthritis
Product: [18F]Fluor-PEG-Folate

Primary endpoint: Our main endpoint is the association between quantitative changes in Folate PET after 4 weeks of anti-TNF treatment and clinical response to therapy up to 26 weeks of treatment in patients with established RA. Clinical follow-up up to 26 weeks will be regarded as golden standard.

Source: https://euclinicaltrials.eu/ctis-public/view/2024-513537-21-02